EU clinical trial 2025-520632-42-00: Evaluation of the efficacy and safety of bimekizumab (BZK) or adalimumab (ADA) in the treatment of anterior chest wall pain associated with active axial spondyloarthritis refractory to NSAIDs with hypothesis of superiority of bimekizumab. Randomized, open-label, in parallel arms, head to head trial (ThoracSPA)
Sponsor: Centre Hospitalier Universitaire Rouen (Hospital/Clinic/Other health care facility). Phase: Therapeutic confirmatory (Phase III). Countries: France (authorised, recruitment pending).
Therapeutic area(s): Diseases [C] - Musculoskeletal Diseases [C05]
Gender: Female, Male. Age: 18-64 years. Enrolment: 150.
Status: Authorised, recruitment pending. Decision date: 2026-04-03. Results received: No. Last updated: 2026-04-03.

Condition(s): axial or predominantly axial SpA with or without psoriasis
Product: Bimzelx 160 mg solution for injection in pre-filled syringe, ADALIMUMAB

Primary endpoint: The primary endpoint will be the ASAS40 response (Spondyloarthritis international Society 40% response) at the 6-month visit. ASAS40 indicates a ≥ 40% improvement in 3 of the 4 domains (BASFI, patient global assessment of disease activity, total spine pain and inflammation (Morning stiffness)
Endpoint(s): The endpoint will be the average spontaneous ACW pain (measured on a NS) between baseline and the 6-month visit using repetitive self-evaluations of pain collected every week at different day times (dedicaded digital tool).

Source: https://euclinicaltrials.eu/ctis-public/view/2025-520632-42-00